EU clinical trial 2023-507430-25-00: Study of PIT565 in relapsed and/or refractory B-cell malignancies
Protocol code: CPIT565A12101
Sponsor: Novartis Pharma AG (Pharmaceutical company). Phase: Human Pharmacology (Phase I)- First administration to humans. Countries: Spain (ended), Belgium (ended), France (ended), Italy (ended).
Therapeutic area(s): Diseases [C] - Neoplasms [C04]
Gender: Female, Male. Age: 18-64 years, 65+ years. Enrolment: 32.
Status: Ended. Start date (EU): 2022-10-03. End date (EU): 2026-01-09. Decision date: 2024-02-14. Results received: No. Last updated: 2026-01-21.
Decision dates by country: IT: 2024-02-20, BE: 2024-02-14, ES: 2024-02-19, FR: 2024-02-19

Condition(s): Relapsed and/or refractory B-cell Non-Hodgkin lymphoma (R/R B-NHL) and relapsed and/or refractory B-cell acute lymphoblastic leukemia (R/R B-ALL)

Source: https://euclinicaltrials.eu/ctis-public/view/2023-507430-25-00